EU clinical trial 2023-503994-39-00: Low dose TamOxifen and LifestylE changes for bReast cANcer prevenTion: a randomized phase II biomarker trial in subjects at increased risk (TOLERANT Study)
Sponsor: Istituto Europeo Di Oncologia S.r.l. (Hospital/Clinic/Other health care facility). Phase: Therapeutic exploratory (Phase II). Countries: Italy (ongoing, recruitment ended).
Therapeutic area(s): Diseases [C] - Neoplasms [C04]
Gender: Female. Age: 18-64 years, 65+ years. Enrolment: 110.
Status: Ongoing, recruitment ended. Start date (EU): 2024-06-21. Decision date: 2023-07-17. Results received: No. Last updated: 2026-05-21.

Condition(s): Healthy women aged 18-70 either carriers of a germline pathogenetic variant (BRCA1, BRCA2, PALB2, ATM, CHEK2, CDH1, RAD51C or RAD51D) or with a breast cancer risk >5% at 10 years (according to the Tyrer-Cuzick model or the Breast Cancer Surveillance Consortium Risk models) or with a previously treated breast IEN (intraepithelial neoplasia).
Product: Nolvadex 10 mg compresse rivestite con film

Primary endpoint: Post intervention levels of circulating Sex Hormone Binding Globulin (SHBG)
Endpoint(s): Changes in time of serum biomarkers: SHBG, insulin, glucose, lipid profile, IGF-I, IGFBP-1, -2 and -3, hs-CRP, adiponectin and leptin;, Changes in time of safety and toxicity, Changes in time of quality of life, Changes in time of BMI and body composition, Changes in time of microbiome composition, Changes in time of immune modulation by expression of inflammation cell signaling genes

Source: https://euclinicaltrials.eu/ctis-public/view/2023-503994-39-00